EU clinical trial 2023-509595-42-00: A Phase III, Randomized, Double-Blind, Clinical Trial of Pembrolizumab (MK-3475) Plus Chemotherapy (XP or FP) Versus Placebo Plus Chemotherapy (XP or FP) as Neoadjuvant/Adjuvant Treatment for Subjects With Gastric and Gastroesophageal Junction (GEJ) Adenocarcinoma (KEYNOTE-585)
Protocol code: MK-3475-585
Sponsor: Merck Sharp & Dohme LLC (Pharmaceutical company). Phase: Therapeutic confirmatory (Phase III). Countries: Poland (ended), Belgium (ended), Italy (ended), France (ended), Germany (ended), Latvia (ended), Estonia (ended), Lithuania (ended).
Therapeutic area(s): Diseases [C] - Neoplasms [C04]
Gender: Female, Male. Age: 18-64 years. Enrolment: 297.
Status: Ended. Start date (EU): 2017-10-31. End date (EU): 2025-04-23. End date: 2025-04-24. Decision date: 2024-05-31. Results received: Yes. Last updated: 2025-05-02.
Decision dates by country: FR: 2024-05-31, EE: 2024-05-31, DE: 2024-06-05, PL: 2024-06-05, BE: 2024-05-31, LV: 2024-05-31, LT: 2024-07-03, IT: 2024-06-17

Condition(s): Gastric and gastroesophageal junction (GEJ) adenocarcinoma
Product: OXALIPLATIN, Placebo to MK-3475, CAPECITABINE, CALCIUM FOLINATE, FLUOROURACIL, CISPLATIN, KEYTRUDA 25 mg/mL concentrate for solution for infusion, DOCETAXEL

Primary endpoint: Event-free Survival (EFS) Per Response Criteria in Solid Tumors Version 1.1 (RECIST 1.1) - Pembrolizumab+Chemotherapy and Placebo+Chemotherapy Treatment Arms, Pathological Complete Response (pathCR) Rate - Pembrolizumab+Chemotherapy and Placebo+Chemotherapy Treatment Arms, Overall Survival (OS) - Pembrolizumab+Chemotherapy and Placebo+Chemotherapy Treatment Arms, Percentage of Participants Who Experience One or More Adverse Events (AEs) - Pembrolizumab+FLOT and Placebo+FLOT Cohorts, Percentage of Participants Who Discontinue Study Treatment Due to an Adverse Event (AE) - Pembrolizumab+FLOT and Placebo+FLOT Cohorts
Endpoint(s): Percentage of Participants Who Experience One or More Adverse Events (AEs) - Pembrolizumab+Chemotherapy and Placebo+Chemotherapy Treatment Arms Separately and in Combination with the Pembrolizumab+FLOT and Placebo+FLOT Cohorts, Percentage of Participants Who Discontinue Study Treatment Due to an Adverse Event (AE) - Pembrolizumab+Chemotherapy and Placebo+Chemotherapy Treatment Arms Separately and in Combination with the Pembrolizumab+FLOT and Placebo+FLOT Cohorts, Disease-free Survival (DFS) Per Response Criteria in Solid Tumors Version 1.1 (RECIST 1.1) - Pembrolizumab+Chemotherapy and Placebo+Chemotherapy Treatment Arms, Overall Survival (OS) - Pembrolizumab+Chemotherapy and Placebo+Chemotherapy Treatment Arms and Pembrolizumab+FLOT and Placebo+FLOT Cohorts, Event-free Survival (EFS) Per Response Criteria in Solid Tumors Version 1.1 (RECIST 1.1) - Pembrolizumab+Chemotherapy and Placebo+Chemotherapy Treatment Arms and Pembrolizumab+FLOT and Placebo+FLOT Cohorts

Source: https://euclinicaltrials.eu/ctis-public/view/2023-509595-42-00